EU clinical trial 2023-508829-28-00: A Phase II clinical trial targeting estrogen receptor negative or PAM50 non-luminal disease with Atezolizumab in combination with Trastuzumab and Vinorelbine in HER2-positive advanced/metastatic breast cancer – ATREZZO Study
Protocol code: SOLTI-1907
Sponsor: Solti Group (Pharmaceutical company). Phase: Therapeutic exploratory (Phase II). Countries: Spain (ongoing, recruitment ended).
Therapeutic area(s): Diseases [C] - Neoplasms [C04]
Gender: Female, Male. Age: 18-64 years. Enrolment: 55.
Status: Ongoing, recruitment ended. Start date (EU): 2021-03-15. Decision date: 2024-07-29. Results received: No. Last updated: 2026-02-02.

Condition(s): Pre- and post-menopausal women or men with advanced (loco regionally recurrent not amenable to curative therapy or metastatic)HER2-positive breast cancer who have progressed to trastuzumab based chemotherapy and AntiHER2-ADC
Product: Tecentriq 1 200 mg concentrate for solution for infusion

Primary endpoint: Overall Response rate (ORR) defined as the proportion of patients with best overall response of complete response (CR) or partial response (PR), as per local investigator´s assessment and according to Response Evaluation Criteria in Solid Tumors (RECIST) version 1.1 criteria.(see Appendix B).
Endpoint(s): Overall Response rate (ORR) defined as the proportion of patients with best overall response of complete response (CR) or partial response (PR), as per local investigator´s assessment and according to Response Evaluation Criteria in Solid Tumors (RECIST) version 1.1 criteria. (see Appendix B, Clinical Benefit Rate at 24 weeks (CBR6) as defined by RECIST 1.1 (including patients with Complete response (CR), Partial response (PR),Stable Disease (SD) > 24 week) • Overall survival • Progression free survival • Duration of response • Time to response, ORR according to RECIST to RECIST 1.1 • Clinical Benefit Rate at 24 weeks (CBR6) as defined by RECIST 1.1 • Progression free survival • Overall survival, AEs according to CTCAE v 5.0.

Source: https://euclinicaltrials.eu/ctis-public/view/2023-508829-28-00